EU clinical trial 2024-514291-41-00: A randomized phase II study of gemcitabine versus reduced-dose combination chemotherapy in fragile patients with non-resectable pancreatic cancer
Protocol code: 2024-514291-41-00
Sponsor: Aalborg University Hospital (Hospital/Clinic/Other health care facility). Phase: Therapeutic exploratory (Phase II). Countries: Denmark (ongoing, recruiting).
Therapeutic area(s): Diseases [C] - Neoplasms [C04]
Gender: Female, Male. Age: 18-64 years, 65+ years. Enrolment: 96.
Status: Ongoing, recruiting. Start date (EU): 2023-10-20. Decision date: 2024-09-10. Results received: No. Last updated: 2025-02-04.

Condition(s): Pancreatic cancer
Product: Gemcitabine Accord 100 mg/ml koncentratas infuziniam tirpalui, Abraxane 5 mg/ml powder for dispersion for infusion., Gemcitabine Accord 100 mg/ml koncentratas infuziniam tirpalui

Primary endpoint: Progression Free Survival (PFS)
Endpoint(s): Overall Survival (OS), Response rate, Number of hospitalizations during treatment, Quality of life assessed by EORTC QLQ-C30 at baseline and after 8, 16, and 24weeks, Cumulative worst toxicity during treatment (Adverse events ≥ grade 3 according to CTCAE version 5.0)

Source: https://euclinicaltrials.eu/ctis-public/view/2024-514291-41-00